EU clinical trial 2023-508015-23-00: A Phase 3, Randomized, Open-label, Multicenter Study to Evaluate the Efficacy and Safety of Sacituzumab Tirumotecan (MK-2870) Maintenance Treatment With or Without Bevacizumab Versus Standard of Care After Second-line Platinum-based Doublet Chemotherapy in Participants With Platinum-sensitive Recurrent Ovarian Cancer (TroFuse 022/ENGOT ov84/GOG-3103)
Protocol code: MK-2870-022
Sponsor: Merck Sharp & Dohme LLC (Pharmaceutical company). Phase: Therapeutic confirmatory (Phase III). Countries: Spain (ongoing, recruiting), Austria (authorised, recruiting), Belgium (ongoing, recruiting), Czechia (ongoing, recruiting), Denmark (ongoing, recruiting), Finland (ongoing, recruiting), France (ongoing, recruiting), Greece (authorised, recruiting), Hungary (authorised, recruiting), Ireland (authorised, recruiting), Italy (ongoing, recruiting), Poland (ongoing, recruiting), Portugal (ongoing, recruiting), Romania (ongoing, recruiting).
Therapeutic area(s): Diseases [C] - Neoplasms [C04]
Gender: Female. Age: 18-64 years, 65+ years. Enrolment: 252.
Start date (EU): 2025-04-11. Decision date: 2025-08-22. Results received: No. Last updated: 2026-07-20.
Decision dates by country: HU: 2025-10-03, PL: 2025-10-10, GR: 2025-08-22, PT: 2025-09-02, IE: 2025-10-31, AT: 2026-03-20, RO: 2025-09-12, BE: 2025-10-08, ES: 2025-03-26, IT: 2025-09-12, CZ: 2025-10-01, DK: 2025-10-17, FI: 2025-09-11, FR: 2025-10-27

Condition(s): Ovarian cancer recurrent
Product: DEXAMETHASONE, BEVACIZUMAB, MK-2870, PARACETAMOL, BEVACIZUMAB, MK-2870

Primary endpoint: Part 1: Number of Participants with One or More Adverse Events (AE), Part 1: Number of Participants who Discontinue Study Intervention Due to an AE, Part 2: Progression-free Survival (PFS)
Endpoint(s): Part 2: Overall Survival (OS), Part 2: Number of Participants with One or More AEs, Part 2: Number of Participants who Discontinue Study Intervention Due to an AE, Part 2: Change from Baseline in European Organisation for Research and Treatment of Cancer Quality of Life Questionnaire-Core 30 (EORTC QLQ-C30) Global Health Status-Quality of Life Score, Part 2: Change from Baseline in EORTC QLQ-C30 Physical Functioning Score, Part 2: Change from Baseline in EORTC QLQ-C30 Role Functioning Score, Part 2: Change from Baseline in EORTC Quality of Life Questionnaire-Ovarian Cancer Module 28 Abdominal/Gastrointestinal Symptom Scale

Source: https://euclinicaltrials.eu/ctis-public/view/2023-508015-23-00